EU clinical trial 2022-502074-16-00: An open-label, single arm study evaluating the activity, safety, and pharmacokinetics of rozanolixizumab in pediatric study participants with moderate to severe generalized myasthenia gravis
Protocol code: MG0006
Sponsor: UCB Biopharma (Pharmaceutical company). Phase: Phase II and Phase III (Integrated). Countries: Italy (ended), Poland (ended).
Therapeutic area(s): Diseases [C] - Nervous System Diseases [C10]
Gender: Female, Male. Age: 0-17 years. Enrolment: 7.
Status: Ended. Start date (EU): 2024-06-14. End date (EU): 2026-06-09. Decision date: 2024-02-01. Results received: No. Last updated: 2026-04-08.
Decision dates by country: PL: 2024-04-22, IT: 2024-02-01

Condition(s): Generalized Myasthenia Gravis
Product: Rozanolixizumab

Primary endpoint: - Occurrence of serious Treatment-Emergent Adverse Events (TEAEs) up to the End of Study (EOS) Visit (up to 18 weeks) - Occurrence of TEAEs leading to permanent withdrawal of Investigational Medicinal Product (IMP) up to the EOS Visit (up to 18 weeks) - Occurrence of Adverse Event(s) of Special Monitoring (AESM) up to the EOS Visit (up to 18 weeks)
Endpoint(s): Percent change in total Immunoglobulin G (IgG) from Baseline at the end of Week 6, Absolute change in total IgG from Baseline at the end of Week 6, Percent change from Baseline in MG-specific autoantibodies (anti-AChR or anti-MuSK) levels at the end of Week 6, Absolute change from Baseline in MG-specific autoantibodies (anti-AChR or anti-MuSK) levels at the end of Week 6, Change from Baseline in myasthenia gravis-activities of daily living (MG-ADL) total score at the end of Week 6, Change from Baseline in Quantitative Myasthenia Gravis (QMG) total score at the end of Week 6, Occurrence of other TEAEs (including headache, nausea, and infusion site reactions) during Treatment Period 1 (TP1) and Observation Period 1(OP1), Evaluation of local tolerability at each scheduled assessment during TP1, Plasma concentration of rozanolixizumab at the 6-week treatment cycle, Incidence of antidrug antibodies (ADAs) at the end of Week 6

Source: https://euclinicaltrials.eu/ctis-public/view/2022-502074-16-00